EU clinical trial 2023-504648-33-00: A Randomised, Double-Blind, Parallel-Group, Placebo-Controlled 28-week Phase III Efficacy and Safety Study of Tezepelumab in Reducing Oral Corticosteroid Use in Adults with Oral Corticosteroid Dependent Asthma (SUNRISE)
Protocol code: SUNRISE
Sponsor: AstraZeneca AB (Pharmaceutical company). Phase: Therapeutic confirmatory (Phase III). Countries: Poland (ended), Czechia (ended).
Therapeutic area(s): Diseases [C] - Respiratory Tract Diseases [C08]
Gender: Female, Male. Age: 18-64 years, 65+ years. Enrolment: 76.
Status: Ended. Start date (EU): 2022-07-19. End date (EU): 2025-03-12. End date: 2025-03-24. Decision date: 2023-09-25. Results received: Yes. Last updated: 2024-11-15.
Decision dates by country: CZ: 2023-09-25, PL: 2023-09-29

Condition(s): Oral Corticosteroid Dependent Asthma
Product: Tezspire 210 mg solution for injection in pre-filled syringe, Tezepelumab placebo product in an accessorized prefilled syringe (APFS)

Primary endpoint: Categorised percent reduction from baseline in the daily maintenance OCS dose at Week 28 whilst maintaining asthma control. The categories for percent change from baseline in daily OCS dose are defined as: 1. ≥ 90% to ≤ 100% reduction 2. ≥ 75% to < 90% reduction 3. ≥ 50% to < 75% reduction 4. > 0% to < 50% reduction 5. no change or any increase.
Endpoint(s): 1. Change from baseline in pre-bronchodilator forced expiratory volume in 1 second (pre-BD FEV1) at Week 28., 2. Proportion of participants with 100% reduction from baseline in daily maintenance OCS dose at Week 28, 3. Proportion of participants with daily maintenance OCS dose ≤ 5 mg at Week 28, 4. Proportion of participants with ≥ 50% reduction from baseline in daily maintenance OCS dose at Week 28, 5. Annualised asthma exacerbation rate (AAER) over 28 weeks, 6. Time to first asthma exacerbation, 7. Change from baseline in • Asthma Control Questionnaire 6 (ACQ-6) score at Week 28 • Weekly mean home peak expiratory flow (PEF) (morning and evening) at Week 28, 8. Change from baseline in: • Standardized Asthma Quality of Life Questionnaire for 12 years and older (AQLQ(s)+12) total score at Week 28 • St George's Respiratory Questionnaire (SGRQ) score at Week 28, 9. Change from baseline in fractional exhaled nitric oxide (FeNO), peripheral blood eosinophils and total serum immunoglobulin E (IgE) at Week 28, 10.Tezepelumab serum trough concentrations at Week 0, 12, and 28, 11.Incidence of anti-drug antibodies (ADAs) at Week 0, 12, 28, and 40

Source: https://euclinicaltrials.eu/ctis-public/view/2023-504648-33-00